EU clinical trial 2023-505163-37-00: A Study Evaluating the Safety and Efficacy of Targeted Therapies in Subpopulations of Patients with Metastatic Colorectal Cancer (INTRINSIC)
Protocol code: WO42758
Sponsor: F. Hoffmann-La Roche AG (Pharmaceutical company). Phase: Human Pharmacology (Phase I)- Other. Countries: Denmark (ongoing, recruiting), Spain (ongoing, recruiting), Germany (ongoing, recruiting), Poland (ongoing, recruiting), Italy (ongoing, recruiting).
Therapeutic area(s): Diseases [C] - Neoplasms [C04]
Gender: Female, Male. Age: 18-64 years, 65+ years. Enrolment: 69.
Status: Ongoing, recruiting. Start date (EU): 2021-10-01. Decision date: 2024-07-08. Results received: No. Last updated: 2026-06-19.
Decision dates by country: PL: 2024-07-24, DE: 2024-07-09, ES: 2024-07-11, DK: 2024-07-08, IT: 2024-07-12

Condition(s): Metastatic Colorectal Cancer

Source: https://euclinicaltrials.eu/ctis-public/view/2023-505163-37-00